EU clinical trial 2025-521888-13-00: A Study Investigating the Safety and Absorption of Different Administration forms of RO7795074, a New Compound that may Potentially be Used in the Treatment of Type 1 Diabetes
Protocol code: BP45861
Sponsor: Genentech Inc. (Pharmaceutical company). Phase: Human Pharmacology (Phase I)- Other. Countries: Netherlands (ended).
Therapeutic area(s): Diseases [C] - Nutritional and Metabolic Diseases [C18]
Gender: Female, Male. Age: 18-64 years. Enrolment: 72.
Status: Ended. Start date (EU): 2025-12-02. End date (EU): 2026-04-22. Decision date: 2025-11-26. Results received: No. Last updated: 2026-04-13.

Condition(s): Overweight or Obese (otherwise healthy)

Source: https://euclinicaltrials.eu/ctis-public/view/2025-521888-13-00